EU clinical trial 2023-509091-42-00: A phase 2, randomised, double-blind, placebo-controlled trial to evaluate safety and local tolerability of four weekly administrations of A24110He in subjects with elevated triglyceride plasma concentrations
Protocol code: LGON-CT-002
Sponsor: Lipigon Pharmaceuticals AB (Pharmaceutical company). Phase: Therapeutic exploratory (Phase II). Countries: Sweden (ended).
Therapeutic area(s): Diseases [C] - Nutritional and Metabolic Diseases [C18]; Diseases [C] - Cardiovascular Diseases [C14]
Gender: Female, Male. Age: 18-64 years, 65+ years. Enrolment: 26.
Status: Ended. Start date (EU): 2024-02-27. End date (EU): 2026-01-08. Decision date: 2024-02-06. Results received: Yes. Last updated: 2025-07-04.
Decision dates by country: SE: 2024-04-19

Condition(s): Moderate to severe hypertriglyceridemia
Product: Actrapid 100 international units/ml solution for injection in vial, Natriumklorid Fresenius Kabi, 9 mg/ml, infusionsvätska, lösning, SODIUM CHLORIDE, Natriumklorid Fresenius Kabi 9 mg/ml, spädningsvätska för parenteral användning, Albumin Baxalta 200 g/l infusionsvätska, lösning, Glucos Fresenius Kabi 200 mg/ml infusionsvätska, lösning, A24110He

Primary endpoint: Physical examination, Assessment of local tolerability, Vital signs: systolic blood pressure (SBP), diastolic blood pressure (DBP), heart rate, body temperature, 12- lead ECG, Safety laboratory tests - Clinical chemistry: creatinine (eGFR), cystatin C (eGFR), ASAT, ALAT, bilirubin, GGT, alkaline phosphatase, albumin, bicarbonate, chloride, phosphate, urea, potassium, calcium, sodium, fasting plasma glucose (FPG), f-insulin, HbA1c, C-reactive protein (CRP), TSH, LDH, Safety laboratory tests - Haematology: haemoglobin, EVF, MCV, MHC, MCHC, erythrocyte count, platelet count, leucocyte count with differential count, haptoglobin, Safety laboratory tests - Coagulation: APTT, INR, Safety laboratory tests - Urinalysis: erythrocytes, glucose, ketones, leucocytes, nitrite, pH, protein, hCG (women of childbearing potential only), albumin, creatinine, urinary albumin/creatinine ratio, Frequency, seriousness, intensity of adverse events (AEs)
Endpoint(s): Plasma concentrations and PK parameters of A24110He. PK parameters to be determined: a) Maximum plasma concentration (Cmax); b) Time to Cmax (Tmax); c) Terminal half-life (t½) after the fourth dose. Cmax and Tmax will be evaluated in sampling frame up to 4 hours after dosing., Fasting triglyceride levels (clinical routine enzymatic assay), Triglyceride-glucose (TyG) index based on fasting triglyceride and glucose levels

Source: https://euclinicaltrials.eu/ctis-public/view/2023-509091-42-00